EU clinical trial 2023-505860-12-00: Efficacy of perioperative duloxetine in patients at high risk for developing chronic postsurgical pain after inguinal hernia repair: a multicenter randomized controlled trial
Protocol code: ICI21/00006l
Sponsor: Parc De Salut Mar (Hospital/Clinic/Other health care facility). Phase: Therapeutic confirmatory (Phase III). Countries: Spain (ongoing, recruiting).
Therapeutic area(s): Diseases [C] - Nervous System Diseases [C10]
Gender: Female, Male. Age: 18-64 years, 65+ years. Enrolment: 294.
Status: Ongoing, recruiting. Start date (EU): 2024-06-26. Decision date: 2023-09-15. Results received: No. Last updated: 2026-03-03.

Condition(s): Chronic postsurgical pain after inguinal hernia repair
Product: Capsules of maltodextrine, Dulotex 30 mg cápsulas duras gastrorresistentes EFG

Primary endpoint: Incidence of CSPS (Chronic post-surgical pain) at 4 months
Endpoint(s): Quality of life by means of questionnaire SF-12, Rate of adverse events perioperatively

Source: https://euclinicaltrials.eu/ctis-public/view/2023-505860-12-00